EU clinical trial 2023-505903-22-00: CLEAR-AKI: A multi-center, randomized, double blinded, placebo-controlled, four arm, parallel-group, dose-finding phase 2b study to investigate the safety and efficacy of TIN816 via a single intravenous infusion in the treatment of participants associated with sepsis- associated acute kidney injury (SA-AKI)
Protocol code: CTIN816B12202
Sponsor: Novartis Pharma AG (Pharmaceutical company). Phase: Therapeutic exploratory (Phase II). Countries: Germany (ended), Austria (ended), Czechia (ended), Belgium (ended), Italy (ended), Hungary (ended), Spain (ended), France (ended).
Therapeutic area(s): Diseases [C] - Cardiovascular Diseases [C14]
Gender: Female, Male. Age: 18-64 years, 65+ years. Enrolment: 138.
Status: Ended. Start date (EU): 2024-07-02. End date (EU): 2026-05-13. End date: 2026-05-14. Decision date: 2024-05-08. Results received: No. Last updated: 2026-03-25.
Decision dates by country: DE: 2024-05-08, CZ: 2024-05-20, AT: 2024-05-15, ES: 2024-05-13, HU: 2024-05-15, IT: 2024-05-14, FR: 2024-05-13, BE: 2024-05-14

Condition(s): Sepsis associated acute kidney injury
Product: TIN816, Sterile 0.9% sodium chloride solution for infusion will be administered as placebo to participants randomized to the placebo treatment. The solution is ready to use in a 100mL infusion bag of 0.9% sodium chloride solution

Primary endpoint: The weighted average of area under the time-corrected endogenous creatinine clearance curve from Day 1 to Day 8 (AUC1-8).
Endpoint(s): Composite endpoint of major adverse kidney events (MAKE) including death, use of RRT and ≥25% reduction from reference in eGFR at Day 90, The weighted average of area under the time-corrected endogenous serum creatinine and endogenous serum cystatin C curve from Day1 to Day14 and Day1 to Day30 The weighted average of area under the time-corrected endogenous creatinine clearance curve from Day5 to Day14 (AUC5-14). Any use of RRT during the study RRT dependency at Day90 Days alive and free of RRT at Day90 Proportion of participants with eGFR decline ≥25% from reference at Day90 Change of KDIGO AKI stage from baseline at Day14., Change of sequential organ failure assessment (SOFA) score from baseline to Day 30, Adverse events and serious adverse events

Source: https://euclinicaltrials.eu/ctis-public/view/2023-505903-22-00